EU clinical trial 2024-519644-33-00: Retinoic acid and sperm production in infertile men
Protocol code: 7345
Sponsor: Les Hopitaux Universitaires De Strasbourg (Hospital/Clinic/Other health care facility). Phase: Therapeutic exploratory (Phase II). Countries: France (authorised, recruitment pending).
Therapeutic area(s): Not possible to specify
Gender: Male. Age: 18-64 years. Enrolment: 100.
Status: Authorised, recruitment pending. Decision date: 2026-04-09. Results received: No. Last updated: 2026-04-09.

Condition(s): oligozoospermia
Product: comprimés placebo à usage thérapeutique 260mg, ISOTRETINOINE ACNETRAIT 40 mg, capsule molle

Primary endpoint: The primary evaluation criterion is sperm production measured after 20 weeks of weekly isotretinoin treatment, compared to that of men who received a placebo
Endpoint(s): Sperm motility and morphology after 20 weeks of weekly isotretinoin treatment

Source: https://euclinicaltrials.eu/ctis-public/view/2024-519644-33-00